EU clinical trial 2024-514889-40-00: InSaKa trial: Insulin dextrose infusion versus nebulized salbutamol versus combination of salbutamol and insulin dextrose in acute hyperkalemia: a randomized clinical trial
Protocol code: RC19_0048
Sponsor: Centre Hospitalier Universitaire De Nantes (Hospital/Clinic/Other health care facility). Phase: Therapeutic use (Phase IV). Countries: France (ended).
Therapeutic area(s): Diseases [C] - Nutritional and Metabolic Diseases [C18]
Gender: Female, Male. Age: 18-64 years, 65+ years. Enrolment: 525.
Status: Ended. Start date (EU): 2019-12-20. End date (EU): 2025-12-20. Decision date: 2024-07-19. Results received: No. Last updated: 2026-03-13.

Condition(s): Hyperkalemia
Product: GLUCOSE, NovoRapid 100 units/ml solution for injection in vial, SALBUTAMOL VIATRIS 5 mg/2,5 ml, solution pour inhalation par nébuliseur en récipient unidose, Humalog 100 units/ml solution for injection in vial, SALBUTAMOL ARROW 5 mg/2,5 ml, solution pour inhalation par nébuliseur en récipient unidose

Primary endpoint: Mean change in the absolute serum potassium level from baseline to 60 minutes (measured in mmol/l)
Endpoint(s): Mean change in the serum potassium level from baseline to 180 minutes and 24 hours, Proportion of patients who had a serum potassium level of 4 mmol/l to less than 4.9 mmol/l at 60, 180 minutes and 24 hours, Proportion of patients who require re-treatment or dialysis at 60, 180 minutes and 24 hours, Proportion of patients with adverse effects at 60 and 180 minutes, Proportion of patients with heart rhythm disorders or high grade atrioventricular bloc that required urgent medication during the first 180 minutes, Proportion of patients with electrocardiographic abnormalities, at 60, 180 minutes and 24 hours, Proportion of major cardiovascular events at 60, 180 minutes and 24 hours

Source: https://euclinicaltrials.eu/ctis-public/view/2024-514889-40-00